EU clinical trial 2024-516909-23-00: A Master Protocol for an Open-Label, Multi-Drug, Multi-Center, Phase II Platform Study to Evaluate the Safety, Tolerability, Pharmacokinetics, and Preliminary Anti-Tumor Activity of Novel Agents or Combinations as Perioperative Treatment in Participants with Locally Advanced Resectable Gastroesophageal Adenocarcinoma (GEMINI-PeriOp GC)
Protocol code: D9804C00001
Sponsor: AstraZeneca AB (Pharmaceutical company). Phase: Therapeutic exploratory (Phase II). Countries: Italy (ongoing, recruitment ended), Spain (ongoing, recruitment ended).
Therapeutic area(s): Diseases [C] - Neoplasms [C04]
Gender: Female, Male. Age: 18-64 years, 65+ years. Enrolment: 17.
Status: Ongoing, recruitment ended. Start date (EU): 2025-10-28. Decision date: 2025-09-01. Results received: No. Last updated: 2026-05-13.
Decision dates by country: IT: 2025-09-01, ES: 2025-09-03

Condition(s): Locally Advanced Resectable Gastroesophageal Adenocarcinoma
Product: AZD0901, Rilvegostomig, DS-8201a

Primary endpoint: -The measures of interest include the incidence of AEs and SAEs, and descriptive statistics summarizing laboratory findings, vital signs, and ECGs., -The analysis will include participants in mITT. -The measure of interest is the pCR rate, which is the proportion of participants with 0% residual viable tumor cells within all resected tissue.

Source: https://euclinicaltrials.eu/ctis-public/view/2024-516909-23-00